EU clinical trial 2022-500520-30-00: A RANDOMIZED DOUBLE BLIND, PLACEBO-CONTROLLED NATIONAL MULTICENTER PHASE 3 TRIAL TO EVALUATE THE EFFICACY OF AZATHIOPRINE FOR THE PREVENTION OF RELAPSE IN PATIENTS WITH MYELIN OLIGODENDROCYTE GLYCOPROTEIN ANTIBODY ASSOCIATED DISEASE (MOG-AD) AFTER A FIRST ATTACK : MOGWAI
Protocol code: 69HCL21_1065
Sponsor: Hospices Civils De Lyon (Hospital/Clinic/Other health care facility). Phase: Therapeutic confirmatory (Phase III). Countries: France (ongoing, recruiting).
Therapeutic area(s): Diseases [C] - Nervous System Diseases [C10]
Gender: Female, Male. Age: 18-64 years, 65+ years. Enrolment: 126.
Status: Ongoing, recruiting. Start date (EU): 2023-03-01. Decision date: 2022-10-10. Results received: No. Last updated: 2024-12-09.

Condition(s): neurology
Product: AZATHIOPRINE, Hydrogénophosphate de calcium dihydraté : Fournisseur Brenntag, PREDNISONE, HYDROCORTISONE

Primary endpoint: The primary endpoint is the time to first relapse, comparing azathioprine-treated vs placebo-treated patients during a randomized control period of a maximum of three years.
Endpoint(s): Number and type of adverse events, including serious adverse events, related to azathioprine and/or steroids., • Global disability at M36 assessed by EDSS (Expanded Disability Status Scale) • Worsening from baseline to M36 of the EDSS • Ambulation status at M36 assessed by the Ambulation Score based on a measurement of the distance the patient is able to walk. • Worsening from baseline to M36 of the Ambulation Score., • Best-corrected high contrast visual acuity at M36 measured using the standard Snellen chart or equivalent. • Worsening from baseline to M36 of visual disability assessed by change of the best- corrected high-contrast visual acuity using the standard Snellen chart or equivalent. • Best-corrected low-contrast visual acuity at M36 using the Sloan Charts at 2.5%, in each eye. • Worsening from baseline to M36 of low-contrast visual acuity using the Sloan Charts at 2.5%, in each eye. • Inner retina, Quality of life will be assessed using the EuroQOL EQ-5D-3L at M36, Compliance to treatment will be described in both arms by the percentage of untaken tablets (left in the blisters) regarding each patient’s time of participation in the study.

Source: https://euclinicaltrials.eu/ctis-public/view/2022-500520-30-00